EU clinical trial 2025-521547-20-00: Herpes zoster after recombinant herpes zoster vaccination - Immediate post-RHZ-vaccination evolution of CMI, HMI and lymphocyte count and typing.
Sponsor: Centre hospitalier universitaire de Liege (Hospital/Clinic/Other health care facility). Phase: Therapeutic use (Phase IV). Countries: Belgium (ongoing, recruitment ended).
Therapeutic area(s): Diseases [C] - Virus Diseases [C02]
Gender: Female, Male. Age: 18-64 years, 65+ years. Enrolment: 10.
Status: Ongoing, recruitment ended. Start date (EU): 2026-06-01. Decision date: 2025-12-04. Results received: No. Last updated: 2026-03-16.

Condition(s): Herpes Zoster virus prevention
Product: Shingrix powder and suspension for suspension for injection Herpes zoster vaccine (recombinant, adjuvanted)

Primary endpoint: The primary endpoint of the study will be the variations and evolution of quantitative values of the 3 parameters over the 3 weeks study period: VZV-specific CMI and quantification, VZV-specific HMI and quantification and Lymphocyte typing

Source: https://euclinicaltrials.eu/ctis-public/view/2025-521547-20-00